EU clinical trial 2024-514022-23-00: Genomics guided targeted post-neoadjuvant therapy in patients with early breast cancer – a multicenter, open-label, umbrella phase-II study (COGNITION-GUIDE)
Protocol code: DKFZ-2019-008
Sponsor: Deutsches Krebsforschungszentrum Stiftung Des Oeffentlichen Rechts (Laboratory/Research/Testing facility). Phase: Therapeutic exploratory (Phase II). Countries: Germany (ongoing, recruiting).
Therapeutic area(s): Diseases [C] - Neoplasms [C04]
Gender: Female, Male. Age: 18-64 years, 65+ years. Enrolment: 240.
Status: Ongoing, recruiting. Start date (EU): 2023-06-23. Decision date: 2024-10-09. Results received: No. Last updated: 2026-03-27.

Condition(s): Early breast cancer
Product: Ipatasertib, Lynparza 100 mg film-coated tablets, Tecentriq 1 200 mg concentrate for solution for infusion, Ipatasertib, INAVOLISIB, Phesgo 600 mg/600 mg solution for injection, Lynparza 150 mg film-coated tablets, INAVOLISIB, Trodelvy 200 mg powder for concentrate for solution for infusion, Phesgo 1200 mg/600 mg solution for injection

Primary endpoint: IDFS* of patients four years after surgery overall (*IDFS: time from surgery to whatever comes first a) ipsilateral invasive breast tumor recurrence, b) local/regional invasive breast cancer recurrence, c) distant recurrence, d) death attributable to any cause incl. breast cancer, e) contralateral invasive breast cancer or f) Second primary non-breast invasive cancer)
Endpoint(s): overall survival (OS), IDFS in each study arm separately, time from surgery to whatever comes first a) distant recurrence, b) death attributable to any cause incl. breast cancer or c) second primary non-breast invasive cancer, Safety including incidence of adverse events

Source: https://euclinicaltrials.eu/ctis-public/view/2024-514022-23-00